EU clinical trial 2023-506876-28-00: ARTEMIS - Effects of ziltivekimab versus placebo on cardiovascular outcomes in patients with acute myocardial infarction.
Protocol code: EX6018-4979
Sponsor: Novo Nordisk A/S (Pharmaceutical company). Phase: Therapeutic confirmatory (Phase III). Countries: Greece (ongoing, recruitment ended), Bulgaria (ongoing, recruitment ended), Germany (ongoing, recruitment ended), Poland (ongoing, recruitment ended), Netherlands (ongoing, recruitment ended), Italy (ongoing, recruitment ended), Denmark (ongoing, recruitment ended), Czechia (ongoing, recruitment ended), France (ongoing, recruitment ended), Spain (ongoing, recruitment ended).
Therapeutic area(s): Diseases [C] - Cardiovascular Diseases [C14]
Gender: Female, Male. Age: 18-64 years, 65+ years. Enrolment: 3915.
Status: Ongoing, recruitment ended. Start date (EU): 2024-08-01. Decision date: 2024-07-25. Results received: No. Last updated: 2026-07-13.
Decision dates by country: NL: 2024-07-29, CZ: 2024-08-01, GR: 2024-07-29, DK: 2024-07-31, BG: 2024-07-30, ES: 2024-07-29, DE: 2024-08-01, FR: 2024-07-25, PL: 2024-07-30, IT: 2024-07-31

Condition(s): The medical condition we are investigating is type 1 AMI (STEMI and NSTEMI). Ziltivekimab is a human monoclonal antibody directed against the interleukin-6 (IL-6) ligand, and currently available clinical data support that ziltivekimab once-monthly reduces inflammation as measured by highsensitivity C-reactive protein (hs-CRP). With the recent proof-of-concept that hs-CRP reduction through inhibition of an upstream pathway leads to reduction in cardiovascular events, it is reasonable to expect that similar inhibition of IL-6 with ziltivekimab also reduces CV risk.The aim of the current study is to demonstrate the efficacy and safety of ziltivekimab in reducing the risk of major adverse cardiovascular events when initiated as early as possible in adult patients with ST-elevation and non-ST-elevation myocardial infarction
Product: ziltivekimab, Ziltivekimab

Primary endpoint: 5.Time to first occurrence of non-fatal MI (a,c), 7.Time to first occurrence of non-fatal stroke (a,d), 10.(a) Based on EAC-confirmed events, 11.(b) including undetermined cause of death, 12.(c) acute MI only, 13.(d) including ischaemic, haemorrhagic and undetermined stroke, 1. Time to first occurence of a 4-component MACE endpoint comprising: CV death (a,b), Non-fatal MI (a,c), Non-fatal stroke (a,d), Ischaemia-driven coronary revascularisation, 2.Number of CV death (a,b), non-fatal MI, non-fatal stroke or ischaemia-driven coronary revascularisation, 3.Time to first occurrence of a composite MACE endpoint consisting of: All-cause mortality (a,b), Non-fatal MI (a,c), Non-fatal stroke (a,d), Ischaemia-driven coronary revascularisation, 4.Number of all-cause mortality (a,b), non-fatal MI (a,c), non-fatal stroke (a,d) or ischaemia-driven coronary revascularisation, 6.Time to first occurrence of MI (c), 8.Time to first occurrence of stroke (d), 9.Time to first occurence of ischaemia-driven coronary revascularisation
Endpoint(s): 5.Time to first occurrence of a 3-component coronary MACE endpoint comprising: CV death (a,b), Non-fatal MI (a,c), Ischaemia-driven coronary revascularisation, 6.Time to first occurrence of a 5-component expanded MACE endpoint comprising: CV death (a,b), non-fatal MI (a,c), non-fatal stroke (a,d), Ischaemia-driven coronary revacularisation, HF hospitalisation (a) or urgent HF visit (a), 7.Time to first occurrence of a 3-component HF endpoint comprising: CV death (a,b), HF hospitalisation (a) or urgent HF visit (a), Outpatient HF visit (a), 9.Time to occurrence of CV death (a,b), 10.Time to occurrence of all-cause death (a,b), 11.(a) Based on EAC-confirmed events, 12.(b) including undetermined cause of death, 13.(c) acute MI only, 14.(d) including ischaemic, haemorrhagic and undetermined stroke, 8.Time to first occurrence of a 2-component HF enpoint comprising: CV death (a, b), HF hospitalisation (a) or urgent HF visit (a), 1.Time to first occurrence of a 3-component MACE endpoint comprising: CV death (a,b), Non-fatal MI (a,c), Non-fatal stroke (a,d), 2.Number of CV death (a,b), non-fatal MI (a,c) or non-fatal stroke (a,d), 3.Time to first occurrence of a composite MACE endpoint consisting of: All-cause mortality (a,b), Non-fatal MI (a,c), Non-fatal stroke (a,d), 4.Number of all-cause mortality (a,b), non-fatal MI (a,c) or non-fatal stroke (a,d)

Source: https://euclinicaltrials.eu/ctis-public/view/2023-506876-28-00